EU clinical trial 2025-520660-18-00: Pharmacological optimization in prevention in Heart Failure: A Sex-gap? (PopS-HF Trial)
Protocol code: AIFA-CARDIO-129
Sponsor: Policlinico San Donato S.p.A. (Hospital/Clinic/Other health care facility). Phase: Therapeutic use (Phase IV). Countries: Italy (authorised, recruiting).
Therapeutic area(s): Diseases [C] - Cardiovascular Diseases [C14]
Gender: Female. Age: 18-64 years, 65+ years. Enrolment: 368.
Status: Authorised, recruiting. Start date (EU): 2026-05-08. Decision date: 2025-11-17. Results received: No. Last updated: 2026-07-31.

Condition(s): Heart Failure
Product: LOSARTAN, LOSARTAN, DAPAGLIFLOZIN, CAPTOPRIL, LISINOPRIL, CANRENONE, PERINDOPRIL, EMPAGLIFLOZIN, SACUBITRIL VALSARTAN, SACUBITRIL VALSARTAN, PERINDOPRIL, SPIRONOLACTONE, FINERENONE, TRANDOLAPRIL, ENALAPRIL, DAPAGLIFLOZIN, OLMESARTAN, BISOPROLOL, LOSARTAN, CARVEDILOL, CANRENONE, NEBIVOLOL, QUINAPRIL, FINERENONE, QUINAPRIL, CAPTOPRIL, BISOPROLOL, RAMIPRIL, IRBESARTAN, METOPROLOL, VALSARTAN, EPLERENONE, FOSINOPRIL, LISINOPRIL, VALSARTAN, OLMESARTAN, METOPROLOL, ENALAPRIL, POTASSIUM CANRENOATE, EPLERENONE, RAMIPRIL, CANDESARTAN, FOSINOPRIL, EMPAGLIFLOZIN, CARVEDILOL, SPIRONOLACTONE, TRANDOLAPRIL, POTASSIUM CANRENOATE, LOSARTAN, NEBIVOLOL, CANDESARTAN, IRBESARTAN

Primary endpoint: Retrospective study: an up-to-date description of the “status quo” of the prescription of GDMT nationally and related inequality regarding sex in patients with HF based on analyses of National Registry data and Mecki Data-base. Prospective study: • all-cause mortality within 1 year or HF readmission or worsening HF.
Endpoint(s): Prospective study: a.the percentage of optimization of each single medical therapy (BB; ACEi, ARB or ARNi;and MRAs and SGLT2i)in women admitted with heart failure, b.effect of such intervention at 1 year:mortality;HF re-admission;worsening HF;quality of life (EQ-5D questionnaire). c.Other endpoints:include changes in biomarkers and changes in the primary and secondary endpoints in pre-determined subgroups including <50vs>50 EF;>vs<65 yr old,presence of diabetes,chronic kidney disease or obesity

Source: https://euclinicaltrials.eu/ctis-public/view/2025-520660-18-00